EU clinical trial 2024-517237-40-00: AZALOX Study: Safety and Efficacy of PXS-5505 with 5-Azacitidine in MDS and CMML Patients
Protocol code: AZALOX
Sponsor: Heidelberg University (Educational Institution). Phase: Phase I and Phase II (Integrated)- Bioequivalence Study. Countries: Germany (ongoing, recruiting).
Therapeutic area(s): Diseases [C] - Neoplasms [C04]
Gender: Female, Male. Age: 18-64 years, 65+ years. Enrolment: 42.
Status: Ongoing, recruiting. Start date (EU): 2025-07-03. Decision date: 2025-04-29. Results received: No. Last updated: 2026-04-28.

Condition(s): Myelodysplastic Neoplasms (MDS) and Chronic Myelomonocytic Leukemia (CMML)

Source: https://euclinicaltrials.eu/ctis-public/view/2024-517237-40-00